EU clinical trial 2024-518884-36-00: Antimalarial prophylactic efficacy of a weekly dose atovaquone-proguanil
Protocol code: SPARE
Sponsor: Universitaetsklinikum Tuebingen AöR (Hospital/Clinic/Other health care facility). Phase: Therapeutic exploratory (Phase II). Countries: Germany (ongoing, recruiting).
Therapeutic area(s): Diseases [C] - Parasitic Diseases [C03]
Gender: Female, Male. Age: 18-64 years. Enrolment: 32.
Status: Ongoing, recruiting. Start date (EU): 2025-11-12. Decision date: 2024-11-21. Results received: No. Last updated: 2026-06-11.

Condition(s): Malaria
Product: Malarone 250/100 mg filmomhulde tabletten, PfSPZ Challenge (NF54), Microcrystalline cellulose PH102 in capsules (for more informations see IMPD)

Primary endpoint: Efficacy endpoint Proportion of protected volunteers. Protection is defined as the absence of amplifying parasitaemia in the peripheral blood for +21 days following CHMI with PfSPZ Challenge (NF54) in volunteers receiving AP (250/100 mg) for chemoprophylaxis. Amplifying parasitaemia is defined as at least one qPCR result above 20 blood-stage parasites per ML followed by a second qPCR result with an at least 4-fold increased blood stage parasitaemia 24-48 hours apartPrimary safety endpoint Numbe
Endpoint(s): Secondary safety endpoint Occurrence of any related AE from time of AP/placebo D0 until the end of the study.

Source: https://euclinicaltrials.eu/ctis-public/view/2024-518884-36-00